EU clinical trial 2023-508588-58-00: A randomized placebo controlled clinical trial of preserving endogenous insulin production with Ixekizumab in newly diagnosed persons with type 1 diabetes
Sponsor: University Of Gothenburg, NU Hospital Group-Vaestra Goetalandsregionen (Educational Institution, Hospital/Clinic/Other health care facility). Phase: Therapeutic exploratory (Phase II). Countries: Sweden (ongoing, recruitment ended).
Therapeutic area(s): Diseases [C] - Hormonal diseases [C19]
Gender: Female, Male. Age: 18-64 years. Enrolment: 127.
Status: Ongoing, recruitment ended. Start date (EU): 2022-10-25. Decision date: 2024-10-25. Results received: No. Last updated: 2025-11-26.
Decision dates by country: SE: 2025-01-07

Condition(s): Diabetes type 1
Product: Taltz 80 mg solution for injection in pre-filled syringe, Placebo - same composition as IMP except for the active substance.

Primary endpoint: The primary endpoint is change in residual insulin secretion measured by stimulated C- peptide two-hour area under the curve profile measured by Mixed Meal Tolerance Test (MMTT) between baseline and week 52.
Endpoint(s): Change in mean Insulin dosage per kilo bodyweight for 24 hours from baseline to week 52., Change in time with glucose levels in range (3.9-10 mmol/l) measured by masked CGM (Libre Pro iQ) from baseline to week 52., Change in time of hypoglycaemia (<3.9 mmol/l) measured by masked CGM (Libre Pro iQ) from baseline to week 52., Difference in HbA1c from baseline to week 52., Change in time in hypoglycaemia (<3.0 mmol/l) measured by masked CGM (Libre Pro iQ) from baseline to week 52., Change in proinsulin/c-peptide ratio in serum as a measure of beta cell stress from baseline to week 52., Change in time in target (3.9-8 mmol/l) measured by masked CGM (Libre Pro iQ) from baseline to week 52., Change in time in hyperglycaemia >10 mmol/l and ≥ 14 mmol/l measured by masked CGM (Libre Pro iQ) from baseline to week 52., Change in glycaemic variability measured by SD, CV and MAGE by masked CGM (Libre Pro iQ) from baseline to week 52., Change in proportion of patients with peak residual insulin secretion measured by MMTT: stimulated C-peptide >0.4 pmol/mL from baseline to week 52., Change in WHO-5 scores from baseline to week 52., Change in DTSQs scores from baseline to week 52., Change in DTSQc scores estimated at week 52., Change in HCS scores from baseline to week 52., Change in PAID scores from baseline to week 52., Change in IPAQ scores from baseline to week 52., The same variables described above regarding primary, secondary and exploratory endpoints will be evaluated when the variable has been measured at a specific time point from baseline to week 4. baseline to week 13 and baseline to week 26.

Source: https://euclinicaltrials.eu/ctis-public/view/2023-508588-58-00